EU clinical trial 2025-520628-11-00: Multi-center, single-arm, phase II clinical trial evaluating efficacy and in-vivo homing of adoptively transferred autologous ex-vivo expanded regulatory T cells in adults with ulcerative colitis
Sponsor: Universitaetsklinikum Erlangen AöR (Hospital/Clinic/Other health care facility). Phase: Therapeutic exploratory (Phase II). Countries: Germany (authorised, recruitment pending).
Therapeutic area(s): Diseases [C] - Digestive System Diseases [C06]
Gender: Female, Male. Age: 18-64 years, 65+ years. Enrolment: 30.
Status: Authorised, recruitment pending. Decision date: 2025-08-21. Results received: No. Last updated: 2025-11-05.

Condition(s): Ulcerative colitis

Primary endpoint: The primary endpoint of this study is the proportion of subjects in clinical remission according to the modified Mayo score at week 12 compared to the day of screening (remission defined as the proportion of subjects with Mayo subscores of 0 for rectal bleeding, 0 or 1 for stool frequency, and 0 or 1 for endoscopy [modified excluding friability]).

Source: https://euclinicaltrials.eu/ctis-public/view/2025-520628-11-00